EU clinical trial 2024-519945-31-00: A 26-week Study Comparing the Efficacy and Safety of Once-weekly Insulin Icodec and Once-daily Insulin Glargine U100, Both in Combination with Insulin Aspart, in Adults with Type 1 Diabetes
Protocol code: NN1436-8182
Sponsor: Novo Nordisk A/S (Pharmaceutical company). Phase: Therapeutic confirmatory (Phase III). Countries: Germany (ongoing, recruitment ended), Romania (ongoing, recruitment ended), Slovakia (ongoing, recruitment ended), Poland (ongoing, recruitment ended).
Therapeutic area(s): Diseases [C] - Nutritional and Metabolic Diseases [C18]
Gender: Female, Male. Age: 18-64 years, 65+ years. Enrolment: 242.
Status: Ongoing, recruitment ended. Start date (EU): 2025-08-21. Decision date: 2025-08-18. Results received: No. Last updated: 2026-02-16.
Decision dates by country: DE: 2025-08-20, RO: 2025-08-25, SK: 2025-08-18, PL: 2025-08-22

Condition(s): Type 1 Diabetes
Product: Lantus SoloStar 100 units/ml solution for injection in a pre-filled pen, Awiqli 700 units/mL solution for injection in pre-filled pen, Awiqli 700 units/mL solution for injection in pre-filled pen, Awiqli 700 units/mL solution for injection in pre-filled pen, Awiqli 700 units/mL solution for injection in pre-filled pen, Awiqli 700 units/mL solution for injection in pre-filled pen, Awiqli 700 units/mL solution for injection in pre-filled pen

Primary endpoint: Change in HbA1c From baseline week 0 (V6) to week 26 (V32). Unit: %-point
Endpoint(s): Change in time in range 3.9– 10.0 mmol/L (70–180 mg/dL). Using CGM system, Dexcom G7, Time spent <3.0 mmol/L (54 mg/dL). Using CGM system, Dexcom G7, Change in time spent >10.0 mmol/L (180 mg/dL). Using CGM system, Dexcom G7, Number of severe hypoglycaemic episodes (level 3), Number of clinically significant hypoglycaemic episodes (level 2) (< 3.0 mmol/L [54 mg/dL], confirmed by BG meter), Number of clinically significant hypoglycaemic episodes (level 2) (< 3.0 mmol/L [54 mg/dL], confirmed by BG meter) or severe hypoglycaemic episodes (level 3), Number of CGM-based clinically significant hypoglycaemic episodes (level 2) (< 3.0 mmol/L [54 mg/dL]). Using CGM system, Dexcom G7, Mean total weekly insulin dose, Change in body weight, Change in ITSQ total score, Change in ADAQ total score

Source: https://euclinicaltrials.eu/ctis-public/view/2024-519945-31-00